EU clinical trial 2025-522099-10-00: Antisense Oligonucleotide Eye Drops against IRS-1 to Optimize Pretransplant Lymphangio-regression Prior to High-Risk Keratoplasty (Olisens-Precon)
Protocol code: Uni-Koeln-5379
Sponsor: University Of Cologne (Educational Institution). Phase: Therapeutic exploratory (Phase II). Countries: Germany (ongoing, recruiting).
Therapeutic area(s): Diseases [C] - Eye Diseases [C11]
Gender: Female, Male. Age: 18-64 years, 65+ years. Enrolment: 10.
Status: Ongoing, recruiting. Start date (EU): 2026-06-05. Decision date: 2026-01-28. Results received: No. Last updated: 2026-01-28.

Condition(s): Pathologically prevascularized corneas due to herpetic keratopathy prior to “high-risk” corneal transplantation (keratoplasty)
Product: Floxal EDO 3 mg/ml Augentropfen, Lösung, Dexa EDO® 1,3 mg/ml Augentropfen, Lösung, OLISENS 0,86 mg/ml, collyre en solution en récipient unidose, Placebo eye drops are nearly identical to the Olisens eye drops, except for the active substance. For details see IMPD_Placebo

Primary endpoint: Relative change in the corneal area covered by CoNV measured by digital standardized slit-lamp images.
Endpoint(s): Best corrected visual acuity measured by ETDRS charts (transformed to LogMAR (Logarithm of the Minimum Angle of Resolution)), Best corrected glare visual acuity measured by ETDRS charts (transformed to LogMAR (Loga-rithm of the Minimum Angle of Resolution)), Vision related Quality of Life assessed by overall score of NEI-VFQ25, Intraocular Pressure measured by Goldmann applanation tonometry, reported as mmHg, Ocular Surface Staining according to Oxford Grading Scale (Grades 0-5), Corneal Sensation measured by length of the nylon monofilament of Cochet-Bonnet esthesiometer when the applied pressure is noticed by the participants, Central Corneal Thickness measured by Scheimpflug Corneal Tomography (Pentacam) or Anterior Segment Optical Coherence Tomography (Casia-2), Vessel Morphometry (vessel thickness, vessel length, vessel regression, vessel recurrence), Quality of Life (Ocular Pain) assessed by overall score of Ocular Pain Assessment Survey (OPAS), Safety: Retinal adverse events (Optical Coherence Tomography), Change in need for subsequent transplantation (as assessed by PI), Compliance of CXL postoperative medication recorded via daily patient self-documentation

Source: https://euclinicaltrials.eu/ctis-public/view/2025-522099-10-00